EU clinical trial 2025-524038-24-00: A Double-blind, Randomized Clinical Trial Evaluating the Efficacy and Safety of Vormatrigine in Adults with Focal Seizures
Protocol code: PRAX-628-322
Sponsor: Praxis Precision Medicines Inc. (Pharmaceutical company). Phase: Therapeutic confirmatory (Phase III). Countries: Poland (authorised, recruitment pending), Germany (authorised, recruitment pending), Czechia (authorised, recruitment pending), Italy (temporarily halted), Spain (temporarily halted).
Therapeutic area(s): Diseases [C] - Nervous System Diseases [C10]
Gender: Female, Male. Age: 18-64 years, 65+ years. Enrolment: 60.
Start date (EU): 2026-05-22. Decision date: 2026-04-10. Results received: No. Last updated: 2026-07-07.
Decision dates by country: IT: 2026-04-23, DE: 2026-04-13, PL: 2026-04-20, ES: 2026-04-23, CZ: 2026-06-09

Condition(s): Focal Epilepsy
Product: Placebo for PRAX-628, PRAX-628, PRAX-628, PRAX-628

Primary endpoint: 50% Responder, defined as at least a 50% reduction in focal seizure frequency from the Observation Period to the Treatment Period
Endpoint(s): Change from baseline in seizure frequency from the Observation Period to the Treatment Period as assessed across the vormatrigine 20 mg, 30 mg and 40 mg dose groups, Seizure Freedom, during the last period, Time to achieve 50% seizure reduction from the Observation Period, Change from baseline in monthly focal seizure frequency from the Observation Period to each month of the Treatment Period for vormatrigine compared with placebo, Impact of vormatrigine compared to placebo on PGI-C and CGI-C, Incidence and severity of TEAEs, including discontinuation of study drug due to TEAEs, Changes in vital sign measurements, Changes in clinical laboratory results, Changes in ECG parameters, Changes in suicidality, as assessed by C-SSRS

Source: https://euclinicaltrials.eu/ctis-public/view/2025-524038-24-00